EU clinical trial 2025-521800-22-00: Immunosuppressive drug bioequivalence in kidney transplant recipients – Prograf and CellCept
Protocol code: GenIS-BID
Sponsor: Oslo University Hospital HF (Hospital/Clinic/Other health care facility). Phase: Therapeutic use (Phase IV). Countries: Norway (ended).
Therapeutic area(s): Diseases [C] - Immune System Diseases [C20]
Gender: Female, Male. Age: 18-64 years, 65+ years. Enrolment: 27.
Status: Ended. Start date (EU): 2025-08-04. End date (EU): 2025-11-13. Decision date: 2025-07-04. Results received: No. Last updated: 2025-07-04.

Condition(s): Organ transplantation
Product: Tacrolimus Ascend 1 mg Hartkapseln, Mycophenolate Mofetil Accord 250 mg kapselit, PROGRAF 1 mg capsule, CellCept 500 mg film-coated tablets

Primary endpoint: AUC0-12 and Cmax of Tac and MPA test:reference (according to EMA bioequivalence guidelines).
Endpoint(s): Tac and MMF pharmacokinetic parameters and variables such as AUC0-12, Cmax, C0, C12, CL/F, popPK model parameters, metagenomic feces analyses, feces derived ex vivo drug conversion rates.

Source: https://euclinicaltrials.eu/ctis-public/view/2025-521800-22-00